EU clinical trial 2024-512215-53-00: A Phase 3 Open-label Rollover Clinical Study of Doravirine/Islatravir (DOR/ISL) Once daily for the Treatment of HIV-1 Infection in Participants Who Previously Received DOR/ISL in a Phase 2 or Phase 3 DOR/ISL Clinical Study
Protocol code: MK-8591A-033
Sponsor: Merck Sharp & Dohme LLC (Pharmaceutical company). Phase: Therapeutic confirmatory (Phase III). Countries: Italy (ongoing, recruitment ended), France (ongoing, recruitment ended).
Therapeutic area(s): Diseases [C] - Virus Diseases [C02]
Gender: Female, Male. Age: 18-64 years, 65+ years. Enrolment: 84.
Status: Ongoing, recruitment ended. Start date (EU): 2021-10-27. Decision date: 2024-07-01. Results received: No. Last updated: 2026-07-29.
Decision dates by country: IT: 2024-08-26, FR: 2024-09-02

Condition(s): HIV infection
Product: MK-8591A

Primary endpoint: Percentage of participants with serious adverse events (SAEs), Percentage of participants who discontinued study treatment due to an adverse event (AE)

Source: https://euclinicaltrials.eu/ctis-public/view/2024-512215-53-00